EU clinical trial 2024-520042-31-00: Aciclovir for HSV-2 MENingitis: A double-blinded randomised controlled trial (AMEN)
Sponsor: Aalborg University Hospital (Hospital/Clinic/Other health care facility). Phase: Therapeutic use (Phase IV). Countries: Denmark (authorised, recruitment pending).
Therapeutic area(s): Diseases [C] - Virus Diseases [C02]; Diseases [C] - Nervous System Diseases [C10]
Gender: Female, Male. Age: 18-64 years, 65+ years. Enrolment: 150.
Status: Authorised, recruitment pending. Decision date: 2025-01-02. Results received: No. Last updated: 2025-01-02.

Condition(s): HSV-2 meningitis
Product: IV and tablet placebo identifical to the active products will be produced by: Euromed Pharma Services S.R.L. Via Abruzzi snc, 20056; Grezzago, Italy www.euromed-pharma.com, Aciclovir Pfizer 25 mg/ml, koncentrat till infusionsvätska, lösning, Valaciclovir Sandoz 500 mg compresse rivestite con film

Primary endpoint: The primary outcome in the current study is the proportion of patients with a TMS >6 at 7 days since randomisation.
Endpoint(s): Proportion of patients with ≤50% reduction in TMS score after 7 days compared with TMS score at randomisation, Unfavourable outcome (E-GOS <7) and all-cause mortality at 7 days, 3 and 12 months since randomisation, Proportion with a headache score of >2 at 7 days since randomisation, Persisting neurological symptoms (sensory or motor nerve) at 7 days, 3 and 12 months since randomisation, Completion of assigned treatment strategy, Peripheral venous line complications (infection or superficial venous thrombosis) during treatment, Duration of admission, Severe adverse events during treatment, Quality of life scores and cognitive evaluations (SF-36, EQ-5D-5L, Mental fatigue Scale) at 7 days as well as 3- and 12-months since randomisation

Source: https://euclinicaltrials.eu/ctis-public/view/2024-520042-31-00